EU clinical trial 2024-511828-14-00: A Multi-Centre, Randomised, Double-Blind, Placebo-Controlled Trial of the Safety and Efficacy of the Oral NLRP3 Inhibitor Dapansutrile in Subjects with Type 2 Diabetes Mellitus Dapan-Dia Study
Protocol code: OLT1177-12
Sponsor: Kantonsspital Baden AG (Hospital/Clinic/Other health care facility). Phase: Therapeutic exploratory (Phase II). Countries: France (ongoing, recruiting), Germany (ongoing, recruiting), Belgium (ongoing, recruiting).
Therapeutic area(s): Diseases [C] - Nutritional and Metabolic Diseases [C18]
Gender: Female, Male. Age: 18-64 years, 65+ years. Enrolment: 230.
Status: Ongoing, recruiting. Start date (EU): 2025-05-13. Decision date: 2025-01-13. Results received: No. Last updated: 2026-03-23.
Decision dates by country: FR: 2025-01-14, BE: 2025-01-13, DE: 2025-01-14

Condition(s): Type II diabetes melittus (10067585)
Product: Dapansutrile, The placebo product is visibly identical to the drug product but contains no drug substance. The qualitative composition of Placebo Tablets is listed in Table 32. Placebo Tablets are free from TSE and BSE. The placebo product is contained in a white, HDPE, round wide-mouth bottle that is induction sealed and closed with a white polypropylene child-resistant plastic cap with polyethylene liner. A polyester coil and appropriately sized desiccant are added to each container. Qualitative Composition of Placebo Tablets: Microcrystalline cellulose (Avicel PH112) Diluent 563.70 mg/unit Crospovidone(Polyplasdone XL) Disintegrant 24.00 mg/unit Colloidal silicon dioxide (Cab-O-Sil M-5P) Glidant 9.30 mg/unit Magnesium stearate (HyQual 2257) Lubricant 3.00 mg/unit; Total 600 mg/unit; An 800-mg tablet weight could not be achieved with the placebo tableting blend; however, the 600-mg placebo tablet was compressed to the thickness range of the active product and is visually identical to the active drug product.

Primary endpoint: Change from baseline in HbA1c at Week 26 for dapansutrile compared to placebo.
Endpoint(s): Change from baseline in body weight and body mass index at weeks 4, 8, 12, 16, 20 and 26, Change from baseline in body waist-to-hip ratio and waist-to-height ratio at weeks 8 and 26, Change from baseline in HbA1c at Weeks 4, 8, 12, 16, and 20, Change from baseline in fasting plasma glucose at Weeks 4, 8, 12, 16, 20, and 26, Change from baseline in β-cell secretory function (β-cell responsivity index) and insulin sensitivity (Si) derived by mathematical modelling of glucose, insulin, and C-peptide after a 2-hour standardized MMT at Weeks 8 and 26, Change from baseline in fasting proinsulin to insulin ratio at Weeks 8 and 26, Change from baseline in glycaemic control (3.4-10.0 mmol/l), measured as percentage of time spent in target glycaemic range, below target range (hypoglycaemia levels between 2.6-3.3 mmol/l and below 2.6 mmol/l), and above target range (hyperglycaemia) as assessed by CGM at Week 26

Source: https://euclinicaltrials.eu/ctis-public/view/2024-511828-14-00